EU clinical trial 2023-506818-45-00: A modular, first time in human, open label, multiple dose, accelerated escalation with cohort expansion study of the safety and pharmacokinetics of intravenous infusion of CP-506, a tumor agnostic Hypoxia Activated Prodrug in patients with HRD/FAD solid tumors or tumor types with high incidence of HRD/FAD in monotherapy or in combination with carboplatin or patients with solid tumor and oligoprogressive disease receiving immune checkpoint inhibitors (ICI): a phase I-IIa clinical trial.
Sponsor: Convert Pharmaceuticals (Pharmaceutical company). Phase: Phase I and Phase II (Integrated)- First administration to humans. Countries: Netherlands (temporarily halted), Belgium (temporarily halted), Spain (authorised, recruitment pending).
Therapeutic area(s): Diseases [C] - Neoplasms [C04]
Gender: Female, Male. Age: 18-64 years, 65+ years. Enrolment: 159.
Start date (EU): 2022-12-13. Decision date: 2024-06-06. Results received: No. Last updated: 2026-07-01.
Decision dates by country: NL: 2024-06-06, BE: 2025-06-30, ES: 2025-07-16

Condition(s): Solid tumors that have a high incidence of Homologous Recombination (HRD) or Fanconi Anemia (FAD) DNA damage repair deficiency.

Source: https://euclinicaltrials.eu/ctis-public/view/2023-506818-45-00